EU clinical trial 2025-523837-25-00: 4TAZPower: A Phase 3b/4, Randomized, Double-Blind, Parallel-Group, Placebo-Controlled, Trial to Evaluate the Efficacy and Safety of Daily Subcutaneous Injections of Elamipretide in Patients with Genetically Confirmed Barth Syndrome
Protocol code: SPIBA-401
Sponsor: Stealth Biotherapeutics Inc. (Pharmaceutical company). Phase: Phase III and phase IV (Integrated). Countries: Ireland (authorised, recruitment pending), Netherlands (authorised, recruitment pending), France (authorised, recruitment pending), Italy (authorised, recruitment pending).
Therapeutic area(s): Diseases [C] - Congenital, Hereditary, and Neonatal Diseases and Abnormalities [C16]
Gender: Male. Age: 0-17 years, 18-64 years, 65+ years. Enrolment: 22.
Status: Authorised, recruitment pending. Decision date: 2026-07-27. Results received: No. Last updated: 2026-08-04.
Decision dates by country: FR: 2026-07-29, IE: 2026-08-04, IT: 2026-07-28, NL: 2026-07-27

Condition(s): Barth Syndrome
Product: Elamipretide, Elamipretide injection placebo

Primary endpoint: Change from Baseline to Week 72 in a composite normalized score of the following three functional tests: 6MWT, 3TUG, and 5XSST
Endpoint(s): Change from Baseline to Week 72 in the 6MWT, Change from Baseline to Week 72 in the 3TUG, Change from Baseline to Week 72 in the 5XSST, Change from Baseline to Week 72 in the Patient Global Impression of Severity Scale (PGI-S), Change from Baseline to Week 72 in the Clinician Global Impression of Severity Scale (CGI-S), Change from Baseline to Week 72 in knee extensor muscle strength as measured by handheld dynamometry (HHD), Change from Baseline to Week 72 in hip flexor muscle strength as measured by HHD

Source: https://euclinicaltrials.eu/ctis-public/view/2025-523837-25-00